EU clinical trial 2023-503946-30-00: A randomized study to investigate central and cerebral hemodynamic effects and volume kinetics of Ringer´s Acetate compared with no intravenous fluids, during experimental hypovolemia compared with euvolemia, in healthy human volunteers.
Sponsor: Oslo University Hospital HF (Hospital/Clinic/Other health care facility). Phase: Therapeutic use (Phase IV). Countries: Norway (ended).
Therapeutic area(s): Diseases [C] - Cardiovascular Diseases [C14]; Phenomena and Processes [G] - Circulatory and Respiratory Physiological Phenomena [G09]
Gender: Female, Male. Age: 18-64 years. Enrolment: 12.
Status: Ended. Start date (EU): 2024-03-02. End date (EU): 2025-10-30. Decision date: 2023-06-26. Results received: No. Last updated: 2024-02-27.

Condition(s): Hypovolemia
Product: Ringer-acetat Fresenius Kabi infusjonsvæske, oppløsning

Primary endpoint: Half-life of cardiac stroke volume relative to baseline
Endpoint(s): Half-life of intravascular volume relative to baseline, Half-life of MCAv integral relative to baseline

Source: https://euclinicaltrials.eu/ctis-public/view/2023-503946-30-00